EU clinical trial 2025-521530-28-00: A phase I/II study of CAR-T cells in AutoiMmune disease resistant to B cell Abrogation - CARAMBA
Protocol code: CARAMBA
Sponsor: Universitaetsklinikum Erlangen AöR (Hospital/Clinic/Other health care facility). Phase: Phase I and Phase II (Integrated)- Other. Countries: Germany (ongoing, recruiting).
Therapeutic area(s): Diseases [C] - Immune System Diseases [C20]
Gender: Female, Male. Age: 18-64 years, 65+ years. Enrolment: 15.
Status: Ongoing, recruiting. Start date (EU): 2026-01-19. Decision date: 2025-11-17. Results received: No. Last updated: 2026-04-10.

Condition(s): Progressive systemic autoimmune disease resistant to B cell depletion
Product: Abecma 260 - 500 x 10^6 cells dispersion for infusion

Primary endpoint: Incidence of any grade ≥ 3 CRS or grade ≥ 3 ICANS, any grade ≥ 3 organ toxicity that does not resolve to grade ≤ 2 within 72 hours, any grade ≥ 3 immune effector cell-associated hemophagocytosis, grade ≥ 2 ICANS and CRS that does not resolve to grade 1 within 7 days following adequate therapy

Source: https://euclinicaltrials.eu/ctis-public/view/2025-521530-28-00